EU clinical trial 2023-503992-88-00: A study to test how kidney problems influence the blood concentrations of efgartigimod
Protocol code: ARGX-113-2201
Sponsor: Argenx (Pharmaceutical company). Phase: Human Pharmacology (Phase I)- Other. Countries: Germany (ended).
Therapeutic area(s): Diseases [C] - Musculoskeletal Diseases [C05]
Gender: Female, Male. Age: 18-64 years, 65+ years. Enrolment: 48.
Status: Ended. Start date (EU): 2023-07-14. End date (EU): 2024-06-12. Decision date: 2023-06-20. Results received: No. Last updated: 2024-02-20.
Decision dates by country: DE: 2023-07-19

Condition(s): renal impairment

Source: https://euclinicaltrials.eu/ctis-public/view/2023-503992-88-00